EU clinical trial 2023-508844-24-00: LIPIOJOINT-2 : A randomized sham-controlled, double blind, multicenter trial on the effect of Genicular Arteries Embolization in symptomatic knee osteoarthritis
Sponsor: Assistance Publique Hopitaux De Paris (Hospital/Clinic/Other health care facility). Phase: Therapeutic confirmatory (Phase III). Countries: France (ongoing, recruiting).
Therapeutic area(s): Diseases [C] - Musculoskeletal Diseases [C05]
Gender: Female, Male. Age: 18-64 years, 65+ years. Enrolment: 130.
Status: Ongoing, recruiting. Start date (EU): 2024-09-30. Decision date: 2024-05-23. Results received: No. Last updated: 2026-05-19.

Condition(s): Knee OsteoArthritis
Product: VISIPAQUE 320 mg d’I/mL, solution injectable, LIPIODOL ULTRA FLUIDE 480 mg/ml, solution injectable, HEPARINE CHOAY 5 000 UI/1 ml, solution injectable, XYLOCAINE 5 mg/ml SANS CONSERVATEUR, solution injectable, Optiray 300 (300 mg I/mL), solution injectable en flacon

Primary endpoint: The primary endpoint is the change of the Visual Analogue Scale (VAS) pain score between randomization and 3 months (0–100 mm: 0 = No Pain, 100 = Worst Possible Pain).
Endpoint(s): • Change of the VAS pain score at 1, 6 and 12 months after randomization, • Change of the patient’s global assessment of her/his health measured by the VAS of EQ-5D questionnaire at 1, 3, 6 and 12 months after randomization, • Change of the Western Ontario and McMaster Universities Arthritis Index (WOMAC) total score and sub-scores (pain, function, stiffness) at 1, 3, 6 and 12 months after randomization, • Change of the Knee injury and Osteoarthritis Outcome Score (KOOS) total and sub-scores (knee pain, function, symptoms, sport, quality of life and stiffness) at D0 and 3 months after randomization, • Change of the Hospital Anxiety and Depression (HAD) scale total score and sub-scores (anxiety and depression) at D0 and 3 months after randomization, • Change in semi-quantitative MRI scoring (Whole-Organ Magnetic Resonance Imaging Score [WORMS], Knee Osteoarthritis Scoring System [KOSS], Boston-Leeds Osteoarthritis Knee Scoring [BLOKS], MRI Osteoarthritis Knee Score [MOAKS]) (3) of the knee at 6 months after randomization, • Description of pain medication at 1, 3, 6 and 12 months, • Description of non-pharmacological treatments at 1, 3, 6 and 12 months, • Number of responder patients under OMERACT-OARSI definition (1) in both groups at 3, 6 and 12 months., • Number of patients reaching an acceptable symptom state at 3, 6 and 12 months., • Number and description of AE/SAE at 1, 3, 6 and 12 months, • Number of events in the target knee including intra-articular injection, GAE, knee surgery at 6 and 12 months, • Medico-economic study: incremental cost-utility ratio, • Change of patient’s 3-item priority function McMaster-Toronto Arthritis Patient Preference Disability Questionnaire (MACTAR) global score at D0 and 3 months after randomization., • The following baseline characteristics will be considered as potential predictors of the 3‑month OMERACT–OARSI response: age, sex, Kellgren and Lawrence score, body mass index (BMI), VAS pain score, and the semi‑quantitative MRI assessments.

Source: https://euclinicaltrials.eu/ctis-public/view/2023-508844-24-00